EU clinical trial 2022-501862-24-00: Randomised, crossover bioequivalence clinical trial of rosuvastatin/ezetimibe 20 mg/ 10 mg film-coated tablets versus rosuvastatin/ezetimibe 20 mg/ 10 mg hard capsules, after a single oral dose administration to healthy volunteers under fasting conditions.
Protocol code: N-ROSEZE-22-274
Sponsor: Laboratorios Normon S.A. (Pharmaceutical company). Phase: Human Pharmacology (Phase I)- Bioequivalence Study. Countries: Spain (ended).
Therapeutic area(s): Not possible to specify
Gender: Female, Male. Age: 18-64 years. Enrolment: 54.
Status: Ended. Start date (EU): 2022-11-25. End date (EU): 2023-01-27. Decision date: 2022-11-22. Results received: Yes. Last updated: 2022-11-22.

Condition(s): Healthy volunteers
Product: Rosuvastatina/Ezetimiba Normon 20 mg/10 mg comprimidos recubiertos con película, Lipocomb 20 mg/10 mg cápsulas duras

Primary endpoint: Rosuvastatine AUC0-t and Cmax., Total ezetimibe: AUC0-72 and Cmax.
Endpoint(s): Rosuvastatine: AUC0-∞, Tmax and residual area., Total Ezetimibe: Tmax.

Source: https://euclinicaltrials.eu/ctis-public/view/2022-501862-24-00